EU clinical trial 2024-518220-72-00: Plasma and intraperitoneal pharmacokinetics of cefiderocol in peritoneal dialysis patients
Sponsor: Medical University Of Vienna (Educational Institution). Phase: Human Pharmacology (Phase I)- Other. Countries: Austria (ongoing, recruiting).
Therapeutic area(s): Diseases [C] - Bacterial Infections and Mycoses [C01]
Gender: Female, Male. Age: 18-64 years, 65+ years. Enrolment: 6.
Status: Ongoing, recruiting. Start date (EU): 2025-05-20. Decision date: 2025-05-14. Results received: No. Last updated: 2025-05-14.

Condition(s): Patients undergoing peritoneal dialysis

Source: https://euclinicaltrials.eu/ctis-public/view/2024-518220-72-00